EU clinical trial 2025-524029-41-00: A Pilot Study on the Use of Gadopiclenol for Enhanced Cardiac MRI in Children with Congenital Heart Conditions: A self-controlled, non-randomised, open-label study to compare the image quality and diagnostic performance of gadopiclenol versus gadoterate meglumine
Protocol code: FSJD-GadoCor-2025
Sponsor: Fundacio Sant Joan De Deu (Patient organisation/association). Phase: Therapeutic confirmatory (Phase III). Countries: Spain (authorised, recruiting).
Therapeutic area(s): Diseases [C] - Congenital, Hereditary, and Neonatal Diseases and Abnormalities [C16]; Diseases [C] - Cardiovascular Diseases [C14]
Gender: Female, Male. Age: 0-17 years, 18-64 years. Enrolment: 30.
Status: Authorised, recruiting. Start date (EU): 2026-06-22. Decision date: 2026-02-02. Results received: No. Last updated: 2026-02-02.

Condition(s): Cardiomyopathy, tetralogy of Fallot, or complex congenital heart disease
Product: Elucirem 0.5 mmol/mL solution for injection, Dotarem 0,5 mmol/ml solución inyectable en vial

Primary endpoint: To measure the overall image quality, including myocardium-to-blood pool contrast, and the detection of myocardial fibrosis using gadopiclenol vs. gadoterate meglumine through the diagnostic confidence, contrast-to-noise ratio (CNR), and signal-to-noise ratio (SNR).
Endpoint(s): Quantitative assessment of late gadolinium enhancement (LGE) volume and mass, diagnostic confidence, SNR, CNR, and left ventricular function., Number of adverse events (AEs).

Source: https://euclinicaltrials.eu/ctis-public/view/2025-524029-41-00